EU clinical trial 2024-517511-70-00: A study to assess the effects of efgartigimod on emasiprubart in healthy adult participants
Protocol code: ARGX-113-2405
Sponsor: Argenx (Pharmaceutical company). Phase: Human Pharmacology (Phase I)- Other. Countries: Belgium (ended).
Therapeutic area(s): Not possible to specify
Gender: Female, Male. Age: 18-64 years, 65+ years. Enrolment: 81.
Status: Ended. Start date (EU): 2024-12-04. End date (EU): 2026-05-28. Decision date: 2024-12-03. Results received: No. Last updated: 2026-06-01.

Source: https://euclinicaltrials.eu/ctis-public/view/2024-517511-70-00